EU clinical trial 2023-509994-22-00: A prospective randomized international multicenter study to compare Short versus Long Adjuvant immunotherapy after radical surgery of stage IIb-c, III and IV cutaneous malignant Melanoma (Grand SLAM)
Sponsor: Uppsala University Hospital, North Estonia Medical Centre Foundation, Vilniaus universiteto ligonine Santaros klinikos VšĮ, Rigas Austrumu kliniska universitates slimnica SIA, Universita Degli Studi Di Perugia (Hospital/Clinic/Other health care facility, Hospital/Clinic/Other health care facility, Hospital/Clinic/Other health care facility, Hospital/Clinic/Other health care facility, Educational Institution). Phase: Therapeutic confirmatory (Phase III). Countries: Finland (ongoing, recruiting), Norway (ongoing, recruiting), Sweden (ongoing, recruiting).
Therapeutic area(s): Diseases [C] - Neoplasms [C04]
Gender: Female, Male. Age: 18-64 years, 65+ years. Enrolment: 1800.
Status: Ongoing, recruiting. Start date (EU): 2024-11-15. Decision date: 2024-10-10. Results received: No. Last updated: 2026-05-19.
Decision dates by country: FI: 2024-10-15, SE: 2024-10-10, NO: 2024-10-10

Condition(s): cutaneous malignant melanoma
Product: KEYTRUDA 25 mg/mL concentrate for solution for infusion, OPDIVO 10 mg/mL concentrate for solution for infusion.

Primary endpoint: Distant metastatic free survival (DMFS) and relapse free survival (RFS).
Endpoint(s): Overall survival (OS)

Source: https://euclinicaltrials.eu/ctis-public/view/2023-509994-22-00